EU clinical trial 2023-505413-25-00: Phase 1 study in Staphylococcus aureus endocarditis
Protocol code: PP-SA-002
Sponsor: Phaxiam Therapeutics (Pharmaceutical company). Phase: Human Pharmacology (Phase I)- Other. Countries: France (ended).
Therapeutic area(s): Diseases [C] - Cardiovascular Diseases [C14]; Diseases [C] - Bacterial Infections and Mycoses [C01]
Gender: Female, Male. Age: 18-64 years, 65+ years. Enrolment: 12.
Status: Ended. Start date (EU): 2024-04-10. End date (EU): 2025-04-01. Decision date: 2023-10-03. Results received: No. Last updated: 2025-03-25.

Condition(s): Infectious S. aureus endocarditis

Source: https://euclinicaltrials.eu/ctis-public/view/2023-505413-25-00